EU clinical trial 2024-511849-19-00: Neo-adjuvant chemotherapy combined with Stereotactic Body Radiotherapy to the primary tumour +/- durvalumab (MEDI4736), +/- oleclumab (MEDI9447) in luminal B breast cancer: a phase ll randomised trial
Protocol code: IJB-LBC-NEOCHECK2018
Sponsor: Institut Jules Bordet (Hospital/Clinic/Other health care facility). Phase: Therapeutic exploratory (Phase II). Countries: Belgium (ongoing, recruitment ended), France (ongoing, recruitment ended).
Therapeutic area(s): Diseases [C] - Neoplasms [C04]
Gender: Female. Age: 18-64 years. Enrolment: 147.
Status: Ongoing, recruitment ended. Start date (EU): 2019-10-17. Decision date: 2024-10-17. Results received: No. Last updated: 2026-02-16.
Decision dates by country: FR: 2024-10-22, BE: 2024-10-17

Condition(s): Luminal B Breast Cancer
Product: CYCLOPHOSPHAMIDE, Paclitaxel 6 mg/mL concentrate for solution for infusion, Doxorubicin 2 mg/ml Concentrate for Solution for Infusion, DURVALUMAB, Oleclumab_IJB2

Primary endpoint: Residual cancer burden (RCB 0-1 vs. RCB 2-3) at time of surgery. RCB 0 is defined as pathological complete response (pCR) and RCB 1 is defined as minimal residual disease. RCB is calculated as a continuous index combining pathologic measurements of the primary tumour (size and cellularity) and nodal metastases (number and size) as defined by Symmans et al. (15).
Endpoint(s): At surgery: • Rate of pCR - ypT0/Tis ypN0, defined as the absence of residual invasive cancer at the time of definitive surgery., Rate of pCR - no DCIS (yp DCIS (ypT0 ypN0), defined as the absence of residual invasive and in situ cancer at time of definitive surgery, Complete pathologic response rate (pCR) of the primary tumour (ypT0/ Tis), irrespective of the response rate of the resected nodal metastases., Complete pathologic response rate (pCR) of the resected nodal metastases (ypN0), irrespective of the response rate of the primary tumour., % of breast conservation surgery in arms 2 and 3 versus arm 1, Change in TIL levels between baseline and the week 6 biopsy., Follow-up Phase: Efficacy endpoints at 3 years and 5 years after surgery will be measured, as defined by the Standardized Definitions for Efficacy End Points in Neoadjuvant Breast Cancer Clinical Trials (NeoSTEEP) (88). The following endpoints will be assessed: event-free survival (EFS), breast cancer event-free survival (BC-EFS), overall survival (OS) and distant recurrence-free survival (DRFS). Furthermore, the occurrence of ipsilateral locoregional recurrence (breast, chestwall or lo

Source: https://euclinicaltrials.eu/ctis-public/view/2024-511849-19-00